EU clinical trial 2024-511970-66-00: A single arm, open label, clinical study of cryopreserved autologous CD34+ cells transduced with lentiviral vector containing human ARSA cDNA, for the treatment of early onset Metachromatic Leukodystrophy (MLD)
Protocol code: 205756
Sponsor: Orchard Therapeutics (Europe) Limited (Pharmaceutical company). Phase: Therapeutic confirmatory (Phase III). Countries: Italy (ended).
Therapeutic area(s): Phenomena and Processes [G] - Genetic Phenomena [G05]
Gender: Female, Male. Age: 0-17 years. Enrolment: 10.
Status: Ended. Start date (EU): 2017-12-13. End date (EU): 2026-03-10. End date: 2026-03-11. Decision date: 2024-05-20. Results received: No. Last updated: 2025-10-03.

Condition(s): Metachromatic Leukodystrophy (MLD)
Product: Libmeldy 2-10 x 10^6 cells/mL dispersion for infusion

Primary endpoint: Gross motor function measure (GMFM) score at 24 months post gene therapy
Endpoint(s): GMFM score post gene therapy at multiple visits over time; • Clinical efficacy at 24 months post gene therapy and multiple visits over time, as measured by: a) Gross Motor Function Classification (GMFC)- MLD score b) Neurological Examinations c) Assessment of Nerve Conduction Velocity (NCV) d) Evaluation of Brain Magnetic Resonance (MR) imaging assessments / parameters (e.g. Modified Loes Score) e) Neurocognitive assessments, • %LV positive clonogenic progenitors in bone marrow (BM) at Day 30 post-gene therapy and at multiple visits over time • Vector copy number (VCN) (in BM mononuclear cells) at Day 30 post-gene therapy and at multiple visits over time • VCN (in peripheral blood [PB] mononuclear cells) at Day 60 post-gene therapy and at multiple visits over time, • The following at Day 60 post-gene therapy and at multiple visits over time: i) Arylsulfatase A (ARSA) activity in Total Peripheral blood mononuclear cells (PBMCs) ii) ARSA activity in PB CD15+ cells iii) ARSA activity in PB CD14+ cells • ARSA activity in cerebral spinal fluid (CSF) at Day 90 post-gene therapy and at multiple visits over time, • Safety and tolerability as measured by adverse events (AEs) reporting; • Conditioning regimen related toxicity and AEs • Non-conditioning related AEs, • Hematological recovery, defined as reconstitution of absolute neutrophil count (ANC) > 500 neutrophils/ µL, associated with evidence of BM recovery (i.e. no hypocellular marrow) by day +60 • Incidence and titers of antibodies against ARSA • Absence of malignancy or abnormal clonal proliferation due to insertional oncogenesis • Absence of Replication Competent Lentivirus (RCL)

Source: https://euclinicaltrials.eu/ctis-public/view/2024-511970-66-00